EU clinical trial 2023-507448-36-00: A Phase III randomised, double-blind, multicentre study to compare the efficacy, safety, pharmacokinetics, and immunogenicity between SB27 (proposed pembrolizumab biosimilar) and Keytruda in subjects with metastatic non-squamous non-small cell lung cancer
Protocol code: SB27-3004
Sponsor: Samsung Bioepis Co. Ltd. (Pharmaceutical company). Phase: Therapeutic confirmatory (Phase III). Countries: Spain (ongoing, recruitment ended), Romania (ongoing, recruitment ended), Germany (ongoing, recruitment ended).
Therapeutic area(s): Diseases [C] - Neoplasms [C04]
Gender: Female, Male. Age: 18-64 years, 65+ years. Enrolment: 96.
Status: Ongoing, recruitment ended. Start date (EU): 2024-02-16. Decision date: 2024-01-16. Results received: No. Last updated: 2026-07-30.
Decision dates by country: ES: 2024-01-16, DE: 2024-01-17, RO: 2024-01-29

Condition(s): Non-small Cell Lung Cancer
Product: CARBOPLATIN, PEMETREXED, KEYTRUDA 25 mg/mL concentrate for solution for infusion, KEYTRUDA 25 mg/mL concentrate for solution for infusion

Primary endpoint: objective response rate (ORR)

Source: https://euclinicaltrials.eu/ctis-public/view/2023-507448-36-00